EU clinical trial 2023-510309-16-00: PAmidronate for Pain in Sternocostoclavicular hyperostosis: the PAPS-study, a double-blind randomized placebo-controlled trial (PAPS)
Sponsor: Academisch Ziekenhuis Leiden (Hospital/Clinic/Other health care facility). Phase: Therapeutic confirmatory (Phase III). Countries: Netherlands (ongoing, recruiting).
Therapeutic area(s): Diseases [C] - Musculoskeletal Diseases [C05]; Diseases [C] - Skin and Connective Tissue Diseases [C17]
Gender: Female, Male. Age: 18-64 years, 65+ years. Enrolment: 70.
Status: Ongoing, recruiting. Start date (EU): 2020-12-08. Decision date: 2024-08-01. Results received: No. Last updated: 2025-01-16.

Condition(s): Inflammation of sternal region, Sternocostoclavicular hyperostosis
Product: Natriumchloride 0,9 %, oplossing voor injectie, Pamipro 3 mg/ml, concentraat voor oplossing voor infusie

Primary endpoint: Change in score of maximal pain on BPI (NRS 0-10) from baseline to 6 months
Endpoint(s): Change in range of motion, Number of patients with mild pain (maximal pain as measured with NRS score in BPI ≤4), Number of patients with 50% reduction in maximal pain (NRS score in BPI), Change in shoulder rating questionnaire and facets of SFA score (among which are ability to dress), Change in general health, quality of life, fatigue, work activity score, physical activity, and partner burden, Change in standard dose of analgesics (including NSAIDs) possible during course of the study as evidence for efficacy of treatment, Evaluation of confounding factors for outcome of treatment such as delay in diagnosis and the amount of baseline tracer uptake, pain and range of motion, Evaluation of a possible neuropathic component of the reported pain, Number of CNO patients exhibiting signs of central sensitization, Association between central sensitization and therapeutic response, Change in biochemical markers of inflammation, Amount of tracer uptake of CNO lesions on Na18F-PET/CT, Spinal involvement, Cost-effectiveness

Source: https://euclinicaltrials.eu/ctis-public/view/2023-510309-16-00